EU clinical trial 2024-517500-11-00: A Phase 1b/2a Dose Escalation Study of BOLD-100 in Combination with FOLFOX Chemotherapy in Patients with Advanced Solid Tumours
Protocol code: BOLD-100-001
Sponsor: Bold Therapeutics Inc. (Pharmaceutical company). Phase: Phase I and Phase II (Integrated)- First administration to humans. Countries: Ireland (ongoing, recruiting), Spain (authorised, recruitment pending), Germany (ongoing, recruiting), Italy (ongoing, recruiting).
Therapeutic area(s): Diseases [C] - Neoplasms [C04]
Gender: Female, Male. Age: 18-64 years, 65+ years. Enrolment: 52.
Start date (EU): 2025-07-15. Decision date: 2024-11-11. Results received: No. Last updated: 2026-03-06.
Decision dates by country: ES: 2026-02-16, IT: 2026-03-04, DE: 2026-02-06, IE: 2024-11-11

Condition(s): Colorectal Cancer, Gastric Cancer, Cholangiocarcinoma, Advanced Solid Gastrointestinal Tumors, Pancreatic Cancer
Product: FOLINIC ACID, FLUOROURACIL, OXALIPLATIN, BOLD-100, FLUOROURACIL

Primary endpoint: Incidence and severity of adverse events (AEs) according to National Cancer Institute Common Terminology Criteria for Adverse Events (NCI CTCAE) Version 5.0;, Incidence of serious adverse events (SAE) and suspected unexpected serious adverse reactions;, Incidence of dose-limiting toxicities (DLT);, Clinically significant changes from baseline in: - Laboratory evaluations (chemistry, hematology, coagulation, urinalysis); - Electrocardiograms; - Vital signs; - Physical examinations; - Eastern Cooperative Oncology Group (ECOG) performance status, Progression Free Survival (PFS), Overall Response Rate (ORR), Overall Survival (OS)

Source: https://euclinicaltrials.eu/ctis-public/view/2024-517500-11-00